EU clinical trial 2024-513340-28-00: An open label, balanced, randomized, single dose, two treatment, two period, two sequence, crossover, bioequivalence study comparing Empagliflozin Tablets 25 mg, manufactured by Sun Pharmaceutical Industries Limited, India with Jardiance (Empagliflozin) 25 mg film-coated tablets, Marketing Authorisation Holder Boehringer Ingelheim International GmbH Binger Strasse 173 55216 Ingelheim am Rhein Germany, in healthy adult, human subjects under fasting condition.
Protocol code: EMPAG-05-24
Sponsor: Sun Pharmaceutical Industries Limited (Pharmaceutical company). Phase: Human Pharmacology (Phase I)- Bioequivalence Study. Countries: Romania (ended).
Therapeutic area(s): Diseases [C] - Nutritional and Metabolic Diseases [C18]
Gender: Female, Male. Age: 18-64 years. Enrolment: 36.
Status: Ended. Start date (EU): 2024-11-19. End date (EU): 2025-01-10. Decision date: 2024-09-23. Results received: No. Last updated: 2024-09-23.

Condition(s): Diabetes

Source: https://euclinicaltrials.eu/ctis-public/view/2024-513340-28-00